EU clinical trial 2024-516437-12-00: A Phase 1b/2 Study of Immune and Targeted Combination Therapies in Participants with RCC (KEYMAKER-U03): Substudy 03C in Participants With Recurrent Disease During or After Anti-PD-(L)1 Adjuvant Therapy
Protocol code: MK-3475-03C
Sponsor: Merck Sharp & Dohme LLC (Pharmaceutical company). Phase: Phase I and Phase II (Integrated)- Other. Countries: Poland (ongoing, recruiting), Spain (ongoing, recruiting), France (ongoing, recruiting).
Therapeutic area(s): Diseases [C] - Neoplasms [C04]
Gender: Female, Male. Age: 18-64 years, 65+ years. Enrolment: 33.
Status: Ongoing, recruiting. Start date (EU): 2025-08-29. Decision date: 2025-08-13. Results received: No. Last updated: 2026-04-06.
Decision dates by country: FR: 2025-08-13, PL: 2025-08-19, ES: 2025-08-14

Condition(s): Clear cell renal cell carcinoma
Product: XL092, XL092, XL092, XL092, Belzutifan

Primary endpoint: Safety Lead In Phase: Number of participants who experience one or more dose-limiting toxicities (DLTs), Safety Lead In Phase: Number of participants who experience one or more adverse events (AEs), Safety Lead In Phase: Number of participants who discontinue study treatment due to an AE, Efficacy Phase: Number of participants who experience one or more DLTs, Efficacy Phase: Number of participants who experience one or more AEs, Efficacy Phase: Number of participants who discontinue study treatment due to an AE, Efficacy Phase: Objective Response (OR)
Endpoint(s): Efficacy Phase: Duration of response (DOR), Efficacy Phase: Progression-free survival (PFS), Efficacy Phase: Overall survival (OS), Efficacy Phase: Clinical benefit rate (CBR)

Source: https://euclinicaltrials.eu/ctis-public/view/2024-516437-12-00